EU clinical trial 2022-502207-30-01: A Proof of Concept, Phase IIa, Open Label Study to Evaluate the Safety and Efficacy of Afamelanotide in Patients with Early Parkinson's Disease
Protocol code: CUV901
Sponsor: Clinuvel Europe Limited (Pharmaceutical company). Phase: Therapeutic exploratory (Phase II). Countries: Spain (ended).
Therapeutic area(s): Diseases [C] - Nervous System Diseases [C10]
Gender: Female, Male. Age: 18-64 years, 65+ years. Enrolment: 6.
Status: Ended. End date (EU): 2024-11-21. Decision date: 2024-06-17. Results received: Yes. Last updated: 2024-06-17.

Condition(s): Parkinson's Disease
Product: PRENUMBRA

Primary endpoint: Assessment of Treatment Emergent Adverse Events including clinically significant changes in laboratory results
Endpoint(s): Changes in α-synuclein levels in plasma from baseline to Day 56±2, Changes in inflammation biomarker in plasma from baseline to Day 56±2, Changes in neuromelanin in the MRI series from screening to Day 56±2, Changes in cognition from baseline to Day 56±2, Changes in clinical improvement baseline to Day 56±2

Source: https://euclinicaltrials.eu/ctis-public/view/2022-502207-30-01